EU clinical trial 2023-508068-31-00: Dupilumab treatment in patients with chronic rhinosinusitis with nasal polyps: the effect on comorbid eosinophilic otitis media
Sponsor: Amsterdam UMC (Hospital/Clinic/Other health care facility). Phase: Therapeutic use (Phase IV). Countries: Netherlands (ongoing, recruiting).
Therapeutic area(s): Diseases [C] - Otorhinolaryngologic Diseases [C09]
Gender: Female, Male. Age: 18-64 years, 65+ years. Enrolment: 50.
Status: Ongoing, recruiting. Start date (EU): 2024-09-11. Decision date: 2024-08-19. Results received: No. Last updated: 2024-08-19.

Condition(s): chronic rhinosinusitis with nasal polyps, eosinophilic otitis media
Product: Dupixent 300 mg solution for injection in pre-filled pen

Primary endpoint: Change of questionnaire scores between baseline and 6 or 12 months of treatment in CRSwNP+EOM patients
Endpoint(s): Change of audiometry outcomes between baseline and 6 or 12 months of treatment, Change of questionnaire scores between baseline and 1, 3, 6 and 12 months of treatment, Change of otoscopic findings between baseline and 1, 3, 6 and 12 months of treatment

Source: https://euclinicaltrials.eu/ctis-public/view/2023-508068-31-00